EU clinical trial 2024-518939-12-00: Single-cell deep phenotyping of B lymphocytes to personalize immunotherapy in patients with Myasthenia Gravis: clinical trial to evaluate the efficacy and safety of Rituximab in generalized AChR-antibody positive Myasthenia Gravis
Protocol code: REFINE_2020
Sponsor: Fondazione Policlinico Universitario Agostino Gemelli IRCCS (Hospital/Clinic/Other health care facility). Phase: Therapeutic confirmatory (Phase III). Countries: Italy (ongoing, recruitment ended).
Therapeutic area(s): Diseases [C] - Nervous System Diseases [C10]
Gender: Female, Male. Age: 18-64 years, 65+ years. Enrolment: 40.
Status: Ongoing, recruitment ended. Start date (EU): 2022-02-28. Decision date: 2024-11-26. Results received: No. Last updated: 2024-11-26.

Condition(s): Generalized Myasthenia Gravis
Product: PREDNISONE, PREDNISONE, SODIUM CHLORIDE, RITUXIMAB

Primary endpoint: Change from baseline in Quantitative Myasthenia Gravis Score (QMG) at week 12 (3 months) of the RCP
Endpoint(s): Change in corticosteroid dosage from week 12 to the end of the RCP, Change from baseline in Myasthenia Gravis Activities of Daily Living (MG-ADL) score at week 12, Change from baseline in Myasthenia Gravis Activities of Daily Living (MG-ADL) score at the end of RCP, Change from baseline in Quantitative Myasthenia Gravis Score (QMG) score at the end of RCP, Proportion of subjects with both (1) ≥ 3-point improvement in MG-ADL at end of the RCP (2) no use of rescue therapy during RCP, Change from baseline in Myasthenia Gravis Quality of Life-15, revised (MGQOL-15r) score at the week 12 and at the end of the RCP, Proportion of patients achieving the status of minimal-manifestation or better at week 12 and the end of the RCP, Proportion of patients requiring rescue therapy during the RCP, Time to first exacerbation, Change in Myasthenia Gravis Composite (MGC) score from baseline to week 12 of the RCP, The safety and tolerability of rituximab as measured by the incidence of t adverse events (AEs), and serious adverse events (SAEs). Laboratory measurements will also be evaluated, Exploratory endpoints: 1. Change in anti-acetylcholine receptor (anti-AChR) antibody titers and correlation with clinical outcomes. 2. B- and T-cell subset flow-cytometry 3. B-cell repertoire profiling (substudy)

Source: https://euclinicaltrials.eu/ctis-public/view/2024-518939-12-00